EU clinical trial 2025-521115-40-00: Phase 2 Study of Zelenectide Pevedotin in Participants with Previously-Treated NECTIN4 Amplified Advanced or Metastatic Non-small Cell Lung Cancer
Protocol code: BT8009-202
Sponsor: Bicycletx Limited (Pharmaceutical company). Phase: Therapeutic exploratory (Phase II). Countries: Italy (ended), Spain (ongoing, recruitment ended), France (ended), Germany (ended).
Therapeutic area(s): Diseases [C] - Neoplasms [C04]
Gender: Female, Male. Age: 18-64 years, 65+ years. Enrolment: 28.
Start date (EU): 2025-09-30. Decision date: 2025-09-09. Results received: No. Last updated: 2026-06-02.
Decision dates by country: FR: 2025-09-11, IT: 2025-09-15, ES: 2025-09-11, DE: 2025-09-09

Condition(s): Advanced or Metastatic Non-small Cell Lung Cancer
Product: Zelenectide Pevedotin, BT8009

Primary endpoint: ORR measured by the percentage of participants who have achieved either a confirmed complete response (CR) or partial response (PR) per RECIST v1.1 as assessed by the Investigator
Endpoint(s): 1. Incidence of treatment-emergent adverse event(AEs) and abnormalities in laboratory, electrocardiogram (ECG) and vital signs, 2. DoR measured by the time from first documentation of objective response (that is subsequently confirmed) per RECIST v1.1 assessed by the Investigator to the first documentation of disease progression (per RECIST v1.1), or to death (due to any cause), whichever occurs first, 3. DCR measured by the percentage of participants who experience a confirmed CR, PR, or stable disease (SD) per RECIST v1.1 assessed by the Investigator, 4. CBR, defined as the proportion of participants with CR, PR or SD ≥16 weeks per RECIST v1.1 assessed by the Investigator, 5. PFS measured by the time from the first day of study drug administration (Day 1) to the first documentation of disease progression (per RECIST v1.1), or to death (due to any cause), whichever occurs first, 6. OS measured by length of time from the first day of study drug administration (Day 1) to death (due to any cause), 7. TTP defined as the time from first dose of zelenectide pevedotin until first documentation of disease progression per RECIST v.1.1 assessed by the Investigator

Source: https://euclinicaltrials.eu/ctis-public/view/2025-521115-40-00